EU clinical trial 2024-520433-76-00: EFfIcacy and Tolerability of FIXed duration teclistamab and talquetamab FOR FRAIL patients with newly diagnosed multiple myeloma (2 cohort study) - the EMN 37 FITFIX FOR FRAIL trial
Protocol code: EMN37
Sponsor: European Myeloma Network B.V., Emn Trial Office S.r.l. Impresa Sociale (Patient organisation/association, Laboratory/Research/Testing facility). Phase: Therapeutic exploratory (Phase II). Countries: Norway (authorised, recruitment pending), Italy (ongoing, recruiting), Spain (ongoing, recruiting), Netherlands (ongoing, recruiting).
Therapeutic area(s): Diseases [C] - Neoplasms [C04]
Gender: Female, Male. Age: 18-64 years, 65+ years. Enrolment: 150.
Start date (EU): 2026-01-08. Decision date: 2025-10-20. Results received: No. Last updated: 2026-02-24.
Decision dates by country: NO: 2025-10-20, NL: 2025-10-27, IT: 2025-10-23, ES: 2025-10-20

Condition(s): Newly Diagnosed Multiple Myeloma
Product: DARZALEX 1800 mg solution for injection, JNJ-64407564, JNJ-64407564, teclistamab, teclistamab

Primary endpoint: PFS at 18 months, defined as the duration from the date of randomization to first documented PD, or death, whichever occurs first.
Endpoint(s): Secondary efficacy endpoints: ● PFS ● OS ● MRD negativity rate at 18 months and over time ● MRD-negative CR at 18 months and over time ● Sustained MRD-negative CR (≥12 months) ● Depth of response defined by the ORR and the rate of sCR, CR, VGPR and PR ● Time to partial response and time to best response ● EFS, with events defined as: PD, death, treatment discontinuation due to toxicity ● PFS2 from the date of randomization to 2nd PD or death, whichever comes first ● TNT, ● Depth of response defined by the ORR (sCR, CR, VGPR and PR) after re-treatment ● MRD-negativity rate after re-treatment, ● Incidence and severity of AEs during initial therapy, TFI and after restarting therapy ● Discontinuation rate due to treatment related toxicity during initial therapy and after restarting therapy, including overall discontinuation rate, discontinuation rate of daratumumab, teclistamab and talquetamab ● Causes of discontinuation of therapy during initial therapy and after restarting therapy ● Incidence, grade and cause of infections [...] (for more information, refer to the protocol)

Source: https://euclinicaltrials.eu/ctis-public/view/2024-520433-76-00